EU clinical trial 2023-508337-14-00: A Phase 2, Randomized, Double-Blinded, Placebo-Controlled, Multicenter Study to Evaluate the Safety, Tolerability, and Efficacy of Empasiprubart in Adults With Dermatomyositis
Protocol code: ARGX-117-2301
Sponsor: Argenx (Pharmaceutical company). Phase: Therapeutic exploratory (Phase II). Countries: Greece (ended), Poland (ended), Italy (ended), Spain (ended).
Therapeutic area(s): Diseases [C] - Musculoskeletal Diseases [C05]
Gender: Female, Male. Age: 18-64 years, 65+ years. Enrolment: 19.
Status: Ended. Start date (EU): 2025-03-18. End date (EU): 2025-09-04. Decision date: 2024-11-13. Results received: No. Last updated: 2025-06-05.
Decision dates by country: PL: 2024-11-24, ES: 2024-11-13, IT: 2024-11-19, GR: 2024-11-20

Condition(s): Myositis, Dermatomyositis
Product: Placebo to ARGX-117 IV concentrate solution for infusion, ARGX-117

Primary endpoint: Incidence of adverse events (AEs) at up to 90 weeks., Percentage of participants discontinuing investigational medicinal product (IMP) due to an adverse event (AE) at up to 25 weeks.
Endpoint(s): Total Improvement Score (TIS) at weeks 13 and 25.

Source: https://euclinicaltrials.eu/ctis-public/view/2023-508337-14-00